EU clinical trial 2024-519727-18-00: A Study of LY4050784 in Participants With Advanced or Metastatic Solid Tumors
Protocol code: J5M-OX-JOXA
Sponsor: Eli Lilly & Co. (Pharmaceutical company). Phase: Human Pharmacology (Phase I)- First administration to humans. Countries: Spain (ongoing, recruiting), Germany (ongoing, recruiting), France (ongoing, recruiting).
Therapeutic area(s): Diseases [C] - Neoplasms [C04]
Gender: Female, Male. Age: 18-64 years, 65+ years. Enrolment: 112.
Status: Ongoing, recruiting. Start date (EU): 2025-11-25. Decision date: 2025-09-15. Results received: No. Last updated: 2025-11-03.
Decision dates by country: ES: 2025-09-22, FR: 2025-11-03, DE: 2025-10-29

Condition(s): Metastatic Solid Tumor; Advanced Solid Tumor; Non-small Cell Lung Cancer; SMARCA4-Deficient Tumor

Source: https://euclinicaltrials.eu/ctis-public/view/2024-519727-18-00